EU clinical trial 2024-511936-28-00: First-in-human study of OT-A201 in patients with selected hematological malignancies and solid tumors
Protocol code: A20101
Sponsor: Onward Therapeutics France (Pharmaceutical company). Phase: Human Pharmacology (Phase I)- First administration to humans. Countries: France (ongoing, recruiting).
Therapeutic area(s): Diseases [C] - Neoplasms [C04]
Gender: Female, Male. Age: 18-64 years, 65+ years. Enrolment: 239.
Status: Ongoing, recruiting. Start date (EU): 2023-05-12. Decision date: 2024-06-14. Results received: No. Last updated: 2026-04-29.

Condition(s): Relapsed/refractory hematological malignancies or advanced/metastatic solid tumors

Source: https://euclinicaltrials.eu/ctis-public/view/2024-511936-28-00